EU clinical trial 2023-508067-70-00: A Phase 1/2a Dose Escalation and Cohort Expansion Study of the Safety, Tolerability, and Efficacy of Anti-LAG-3 Monoclonal Antibody (BMS-986016) Administered Alone and in Combination with Anti-PD-1 Monoclonal Antibody (Nivolumab, BMS-936558) in Advanced Solid Tumors
Protocol code: CA224-020
Sponsor: Bristol Myers Squibb International Corporation (Pharmaceutical company). Phase: Phase I and Phase II (Integrated)- Other. Countries: Finland (ended), Norway (ended), Denmark (ended), France (ended), Italy (ended), Austria (ended), Germany (ended), Spain (ended), Netherlands (ended).
Therapeutic area(s): Diseases [C] - Neoplasms [C04]
Gender: Female, Male. Age: 0-17 years, 18-64 years, 65+ years. Enrolment: 1003.
Status: Ended. Start date (EU): 2015-04-15. End date (EU): 2025-02-03. End date: 2025-02-04. Decision date: 2024-02-21. Results received: Yes. Last updated: 2025-01-14.
Decision dates by country: DK: 2024-02-21, FI: 2024-02-21, NO: 2024-02-21, AT: 2024-06-06, DE: 2024-02-25, ES: 2024-02-21, IT: 2024-02-23, NL: 2024-02-21, FR: 2024-02-26

Condition(s): Neoplasms by site
Product: Nivo 240 mg and Rela 80 mg per vial, OPDIVO 10 mg/mL concentrate for solution for infusion., Relatlimab

Primary endpoint: Proportion of subjects with Adverse Events (AEs), Proportion of subjects with Serious Adverse Events (SAEs), Proportion of Deaths, Proportion of subjects with laboratory abnormalities in blood, Proportion of subjects with laboratory abnormalities in blood serum, Proportion of subjects with laboratory abnormalities in urine, Objective response rate (ORR), Disease control rate (DCR), Duration of response (DOR), Number of AEs in the Broad Scope MedDRA Anaphylactic Reaction SMQ, Proportion of subjects with AEs leading to discontinuation of treatment
Endpoint(s): Maximum observed serum concentration (Cmax) of BMS-986016 administered both alone and in combination with nivolumab, Time of maximum observed serum concentration (Tmax) of BMS- 986016 administered both alone and in combination with nivolumab, Trough observed serum concentration (Ctrough) of BMS-986016 administered both alone and in combination with nivolumab, Concentration at the end of a dosing interval (Ctau) [Eg: concentration at 336 hours] of BMS-986016 administered both alone and in combination with nivolumab, Area under the concentration-time curve in one dosing interval [AUC(TAU)] of BMS-986016 administered both alone and in combination with nivolumab, Total body clearance (CLT) of BMS-986016 administered both alone and in combination with nivolumab, Volume of distribution at steady state (Vss) of BMS-986016 administered both alone and in combination with nivolumab, Effective elimination half-life that explains the degree of AUC accumulation observed (T-HALFeff AUC) of BMS- 986016 administered both alone and in combination with nivolumab, Effective elimination half-life that explains the degree of Cmax accumulation observed (T-HALFeff Cmax) of BMS-986016 administered both alone and in combination with nivolumab, Accumulation index; ratio of AUC(TAU) at steady state to AUC(TAU) after the first dose (AI_AUC) of BMS-986016 administered both alone and in combination with nivolumab, Cmax accumulation index; ratio of Cmax at steady state to Cmax after the first dose (AI_Cmax) of BMS-986016 administered both alone and in combination with nivolumab, Ctau accumulation index; ratio of Ctau at steady state to Ctau after the first dose (AI_Ctau) of BMS-986016 administered both alone and in combination with nivolumab, Degree of fluctuation (DF) or fluctuation index ([Cmax - Ctau]/Css,avg]) of BMS-986016 administered both alone and in combination with nivolumab, Immunogenicity measured by anti-drug antibody (ADA) for BMS- 986016 (all participants) and nivolumab, QTc interval from centrally read electrocardiograms (ECGs), Best overall response (BOR), Objective response rate (ORR), Disease control rate (DCR), Duration of response (DOR), Progression-free survival (PFS) rates, Overall survival (OS), Number of AEs in the Narrow Scope MedDRA Anaphylactic Reaction SMQ

Source: https://euclinicaltrials.eu/ctis-public/view/2023-508067-70-00